EU clinical trial 2023-509876-40-00: A Randomized, Double-blind, Placebo-Controlled, Phase 2 Study to Evaluate the Efficacy, Safety, Tolerability, Pharmacokinetics, and Pharmacodynamics of Intravenous TAK-341 in Subjects With Multiple System Atrophy
Protocol code: TAK-341-2001
Sponsor: Takeda Development Center Americas Inc. (Pharmaceutical company). Phase: Therapeutic exploratory (Phase II). Countries: Denmark (ended), Italy (ended), Portugal (ended), Spain (ended), Germany (ended), France (ended), Austria (ended).
Therapeutic area(s): Diseases [C] - Nervous System Diseases [C10]
Gender: Female, Male. Age: 18-64 years, 65+ years. Enrolment: 101.
Status: Ended. Start date (EU): 2022-11-22. End date (EU): 2025-07-28. End date: 2025-07-29. Decision date: 2024-09-09. Results received: Yes. Last updated: 2025-02-10.
Decision dates by country: ES: 2024-09-09, DK: 2024-09-11, FR: 2024-11-13, IT: 2024-09-16, AT: 2024-10-28, DE: 2024-10-10, PT: 2024-09-11

Condition(s): Multiple System Atrophy
Product: HUMAN IGG1 LAMBDA MONOCLONAL ANTIBODY AGAINST ALFA-SYNUCLEIN, SALINE, HUMAN IGG1 LAMBDA MONOCLONAL ANTIBODY AGAINST ALFA-SYNUCLEIN

Primary endpoint: Change from baseline to Week 52 on UMSARS Part I, minus the sexual function item, with collapse of the normal and mild ratings on each item with TAK-341 compared with placebo.
Endpoint(s): Change from baseline to Week 52 on the 11-item UMSARS specified by Palma et al. 2021 al 2021 with TAK-341 compared with placebo, Change from baseline to Week 52 on the UMSARS total score (UMSARS Part I + Part II) with TAK-341 compared with placebo., Change from baseline to Week 52 on the UMSARS Part I score minus the sexual function item (without collapse of ratings of scale items) with TAK-341 compared with placebo., Change from baseline to Week 52 on the UMSARS Part II score with TAK341 compared with placebo., Change from baseline to Week 52 on the CGI-S score with TAK-341 compared with placebo., Change from baseline to Week 52 on the SCOPA-AUT total score with TAK-341 compared with placebo., Overall survival at 52 weeks with TAK-341 compared with placebo., Change from baseline to Week 52 on levels of CSF free αSYN with TAK341 compared with placebo., 09. Serum PK parameters, if feasible, will include but not be limited to the following: – Cmax. – tmax. – Area under the serum concentration-time curve during a dosing interval (AUCτ).", CSF concentrations of TAK-341., Incidence of treatment-emergent adverse events (TEAEs), Incidence of clinically significant abnormal values for clinical laboratory evaluations, vital signs, ECG parameters, and the Columbia-Suicide Severity Rating Scale (C-SSRS)., Findings from clinical laboratory evaluations, vital signs, ECG, C-SSRS, physical examination, neurological examination, Incidence of ADAs

Source: https://euclinicaltrials.eu/ctis-public/view/2023-509876-40-00